EU clinical trial 2024-514765-19-01: Mesalamine for colorectal cancer prevention program in Lynch syndrome
Sponsor: Karolinska Institutet (Educational Institution). Phase: Therapeutic exploratory (Phase II). Countries: Sweden (ongoing, recruitment ended), Denmark (ongoing, recruitment ended).
Therapeutic area(s): Diseases [C] - Neoplasms [C04]; Diseases [C] - Congenital, Hereditary, and Neonatal Diseases and Abnormalities [C16]
Gender: Female, Male. Age: 18-64 years, 65+ years. Enrolment: 150.
Status: Ongoing, recruitment ended. Start date (EU): 2021-08-12. Decision date: 2024-11-27. Results received: No. Last updated: 2025-03-25.
Decision dates by country: DK: 2024-11-29, SE: 2024-11-27

Condition(s): Lynch syndrome, which is increasing the risk of developing colorectal cancer
Product: Pentasa Sachet 2 g depotgranulat, Pentasa PLACEBO Sachet 2g in the granule formulation specifically designed to resemble the active drug product

Primary endpoint: Occurrence of any colorectal neoplasia (both benign and malignant tumors)
Endpoint(s): The number of colorectal neoplasia (both benign and malignant tumors) per patient, The tumor progress in the 4 ordered stages, The dependence of treatment effects on history of colorectal cancer, sex and patients age (<45 years and ≥45 years), Safety data are described and compared between groups in an exploratory manner

Source: https://euclinicaltrials.eu/ctis-public/view/2024-514765-19-01